EU clinical trial 2022-500758-41-00: A MULTI-CENTER, RANDOMIZED, DOUBLE-BLIND, PLACEBO-CONTROLLED MULTIPLE ASCENDING DOSE STUDY TO EVALUATE THE SAFETY AND TOLERABILITY OF QRL-201 IN AMYOTROPHIC LATERAL SCLEROSIS FOLLOWED BY AN OPEN-LABEL EXTENDED DOSING PERIOD
Protocol code: QRL-201-01
Sponsor: Quralis Corp. (Laboratory/Research/Testing facility). Phase: Human Pharmacology (Phase I)- First administration to humans. Countries: Netherlands (ongoing, recruitment ended), Germany (ongoing, recruitment ended), Belgium (ongoing, recruitment ended), Ireland (ongoing, recruitment ended).
Therapeutic area(s): Diseases [C] - Nervous System Diseases [C10]
Gender: Female, Male. Age: 18-64 years, 65+ years. Enrolment: 35.
Status: Ongoing, recruitment ended. Start date (EU): 2023-08-15. Decision date: 2023-05-22. Results received: No. Last updated: 2026-07-30.
Decision dates by country: BE: 2023-05-22, NL: 2023-05-26, IE: 2023-05-26, DE: 2023-05-30

Condition(s): Amyotrophic lateral sclerosis

Source: https://euclinicaltrials.eu/ctis-public/view/2022-500758-41-00